EU clinical trial 2023-505969-80-00: Intraoperative clonidine for postoperative pain management in patients undergoing spine surgery: a prospective, randomized, blinded, placebo-controlled trial
Sponsor: Aarhus Universitetshospital (Hospital/Clinic/Other health care facility). Phase: Therapeutic exploratory (Phase II). Countries: Denmark (ended).
Therapeutic area(s): Diseases [C] - Musculoskeletal Diseases [C05]
Gender: Female, Male. Age: 18-64 years, 65+ years. Enrolment: 120.
Status: Ended. Start date (EU): 2023-09-05. End date (EU): 2024-03-12. Decision date: 2023-08-29. Results received: Yes. Last updated: 2023-08-29.

Condition(s): Degenerative spine diseases
Product: Natriumklorid Fresenius Kabi 9 mg/ml, Clotaxip, injektionsvæske, opløsning, Natriumklorid 9 mg/ml "Fresenius Kabi", solvens til parenteralt brug

Primary endpoint: The primary outcome is postoperative opioid consumption within the first 3 hours after arrival at the PACU
Endpoint(s): Postoperative opioid consumption within the first 6 hours after arrival at the PACU, Daily opioid consumption after 1 month, Intensity of pain at rest and during coughing at 0, 30, 60, 90 and 120 minutes after arrival at the PACU, measured on a Numeric Rating Scale (NRS, 0-10), Sedation at 0, 60, and 120 minutes after arrival at the PACU (Ramsey Sedation Score 1-6), Nausea and/or vomiting at 0, 60, and 120 minutes after arrival at the PACU (yes/no), Time for discharge from the PACU, Length of hospital stay

Source: https://euclinicaltrials.eu/ctis-public/view/2023-505969-80-00